EU clinical trial 2022-502274-16-00: A Double Blind, Multicentre, Randomised Three-Period, Three-Treatment, Cross-Over Study To Evaluate The Effect of BGF MDI, BFF MDI and Placebo MDI on Exercise Parameters In Participants with Chronic Obstructive Pulmonary Disease (ATHLOS)
Protocol code: D5988C00001
Sponsor: AstraZeneca AB (Pharmaceutical company). Phase: Phase III and phase IV (Integrated). Countries: Germany (ended), Spain (ended).
Therapeutic area(s): Diseases [C] - Respiratory Tract Diseases [C08]
Gender: Female, Male. Age: 18-64 years, 65+ years. Enrolment: 160.
Status: Ended. Start date (EU): 2023-10-19. End date (EU): 2026-01-13. End date: 2026-01-22. Decision date: 2023-09-18. Results received: No. Last updated: 2026-02-13.
Decision dates by country: ES: 2024-01-17, DE: 2023-09-08

Condition(s): Chronic Obstructive Pulmonary Disease
Product: Trixeo Aerosphere 5 micrograms/7.2 micrograms/160 micrograms pressurised inhalation, suspension, Placebo pressurized inhalation suspension, SALBUTAMOL

Primary endpoint: Isotime Inspiratory Capacity (IC).
Endpoint(s): Constant work rate cycle ergometry endurance time., Isotime dyspnea: isotime dyspnea Numerical Rating Scale (NRS)., - Static lung volumes: Functional Residual Capacity (FRC), Total Lung Capacity (TLC), Residual Volume (RV), Residual Volume/ Total Lung Capacity (RV/TLC), specific airway conductance (sGaw), and Inspiratory Capacity (IC)., Exercise endurance time: constant work rate cycle ergometry endurance time., - Adverse Events (Serious Adverse Events and Adverse Event Leading to Discontinuation of Study Intervention only) (AEs (SAEs and DAEs only)). - Vital signs.

Source: https://euclinicaltrials.eu/ctis-public/view/2022-502274-16-00